EU clinical trial 2024-518628-57-00: A 20-Week Multicenter, Randomized, Double-Blind, Placebo-Controlled Trial of EPX-100 (Clemizole Hydrochloride) as Adjunctive Therapy in Children and Adult Participants with Dravet Syndrome (ARGUS Trial)
Protocol code: EPX-100-001
Sponsor: Epygenix Therapeutics Inc. (Pharmaceutical company). Phase: Therapeutic confirmatory (Phase III). Countries: Hungary (ongoing, recruiting), Poland (ongoing, recruiting), Spain (ongoing, recruiting).
Therapeutic area(s): Diseases [C] - Nervous System Diseases [C10]
Gender: Female, Male. Age: 0-17 years, 18-64 years. Enrolment: 32.
Status: Ongoing, recruiting. Start date (EU): 2023-08-01. Decision date: 2024-12-10. Results received: No. Last updated: 2026-01-27.
Decision dates by country: ES: 2024-12-10, HU: 2024-12-14, PL: 2024-12-16

Condition(s): Dravet syndrome
Product: Apart from the active substance, the placebo is identical to the investigational medicinal product.

Primary endpoint: The percent change in CMS-28 in the Maintenance Period relative to baseline.

Source: https://euclinicaltrials.eu/ctis-public/view/2024-518628-57-00